EU clinical trial 2024-519637-32-00: PANACEA : Effect of PrehAbilitation by NutritionAl supplementation with Cannabidiol on skeletal muscle mass and mitochondrial function in hEad and neck cAncer : a proof of concept controlled randomized trial
Protocol code: AOI 2022 SAROUL
Sponsor: University Hospital Of Clermont-Ferrand (Hospital/Clinic/Other health care facility). Phase: Therapeutic exploratory (Phase II). Countries: France (authorised, recruitment pending).
Therapeutic area(s): Diseases [C] - Otorhinolaryngologic Diseases [C09]
Gender: Female, Male. Age: 18-64 years, 65+ years. Enrolment: 30.
Status: Authorised, recruitment pending. Decision date: 2025-09-16. Results received: No. Last updated: 2026-01-30.

Condition(s): Head and Neck Cancer
Product: PLACEBO, Arvisol 150mg

Primary endpoint: Change of at least 50% in muscle mitochondrial activity between the time of the panendoscopy and the time of surgery (or of the consultation, if no surgery is planned for the therapeutic management of the patient)
Endpoint(s): Evaluation of tolerance to CBD by measuring appetite and the presence of digestive disorders (particularly in terms of nausea and vomiting) on a daily basis during the period of addition of CBD to the nutritional supplementation., Présence de signes de sevrage et ou de manques au CBD dans les 7 jours suivant l’arrêt de la consommation de CBD, Measures the first 3 days of taking CBD then weekly during the period of CBD consumption and daily for 7 days after stopping CBD consumption and daily consumption of tobacco and alcohol, Muscular functional capacity assessed before panendoscopy and after the addition of CBD to nutritional supplementation by forearm grip strength tests and by the short physical performance battery test, Muscle volume and qualitative muscle analysis by calculation of the muscle mass index at the level of the 3rd lumbar vertebra by CT method and evaluation of lean mass and muscle mass by impedancemetric technique before panendoscopy and at the end of the addition of CBD to nutritional supplementation, Measurement of systemic inflammation by calculating the systemic inflammatory response index, Measurement of tumor evolution between panendoscopy and stopping the addition of CBD to nutritional supplementation by CT method according to RECIST 4.1 criteria

Source: https://euclinicaltrials.eu/ctis-public/view/2024-519637-32-00